EU clinical trial 2024-511768-97-01: A multicenter, open-label, randomized, phase II clinical trial comparing safety and durable overall response rate (DOR) at 56 days in patients with steroid resistant severe acute GvHD after allogeneic hematopoietic stem cell transplantation treated with decidua stromal cells (DSC) or best available treatment (BAT)
Sponsor: Oslo Universitetssykehus HF (Hospital/Clinic/Other health care facility). Phase: Therapeutic exploratory (Phase II). Countries: Sweden (ended), Norway (ended), Denmark (ended).
Therapeutic area(s): Diseases [C] - Immune System Diseases [C20]
Gender: Female, Male. Age: 18-64 years, 65+ years. Enrolment: 45.
Status: Ended. Start date (EU): 2024-11-20. End date (EU): 2026-04-21. Decision date: 2024-11-20. Results received: No. Last updated: 2026-03-04.
Decision dates by country: NO: 2024-11-22, DK: 2024-11-22, SE: 2024-11-20

Condition(s): Graft vs Host Disease
Product: Decidua Stromal Cell 2.0, Decidua Stromal Cell 1.4, Decidua Stromal Cell 1.0

Primary endpoint: Documenting AEs and SAEs and determining causality in relation to DSC. Causality of AEs and SAEs will be assessed by the Investigator., Durable Overall response rate (DOR) at Day 56 after randomization, defined as the proportion of patients in each arm demonstrating a complete response (CR) or partial response (PR) at day 28 and maintain a CR or PR at day 56 without requirement for additional systemic therapies for an earlier progression, mixed response or nonresponse.
Endpoint(s): Proportion of patients in each arm who achieve a complete response (CR) or partial response (PR) at Day 28., Overall survival (OS), defined as the time from the date of randomization to the date of death due to any cause., Non-relapse mortality (NRM), defined as the time from date of randomization to death not preceded by hematologic disease relapse/progression., Proportion of patients in each treatment arm who develop infections or other transplant related complications., Safety and tolerability including myelosuppression, infections and bleeding will be assessed by monitoring the frequency, duration and severity of Adverse Events including occurrence of any secondary malignancies, infections, by performing physical exams and evaluating changes in vital signs from baseline, routine serum chemistry, hematology results and coagulation profile., For Norway: Event-free survival, defined as the time from the date of randomization to the date of hematologic disease relapse/ progression, graft failure or death due to any cause.>, Exploratory endopint: Weekly cumulative steroid dose for each patient up to Day 56 and Day 84 or end of treatment will be calculated., Exploratory endpoing: Malignancy relapse/progression (MR), defined as the time from date of randomization to hematologic malignancy relapse or progression. Calculated for patients with underlying hematologic malignant disease., Exploratory endpoint: Chronic GvHD, defined as the diagnosis of any cGvHD including mild, moderate and severe according to NIH criteria. (see Appendix 3), Exploratory endpoint: Changes in immune reconstitution after aGvHD per randomization arm., Exploratory endpoint: Evaluation of patients´ self-experienced well-being (Quality of Life)(FACT-BMT version 4)., Exploratory endpoint for Sweden and Denmark: Event-free survival, defined as the time from the date of randomization to the date of hematologic disease relapse/ progression, graft failure or death due to any cause.

Source: https://euclinicaltrials.eu/ctis-public/view/2024-511768-97-01